EU clinical trial 2023-505043-39-00: A Phase 3, Multinational, Long-Term Follow-Up Study to Evaluate Safety and Efficacy in Subjects Who Have Previously Received SRP-9001 in a Clinical Study (EXPEDITION)
Protocol code: SRP-9001-305
Sponsor: Sarepta Therapeutics Inc. (Pharmaceutical company). Phase: Therapeutic confirmatory (Phase III). Countries: Spain (ongoing, recruiting), Italy (ongoing, recruiting), Belgium (ongoing, recruiting), Germany (ongoing, recruiting).
Therapeutic area(s): Diseases [C] - Musculoskeletal Diseases [C05]
Gender: Male. Age: 0-17 years, 18-64 years. Enrolment: 74.
Status: Ongoing, recruiting. Start date (EU): 2024-05-24. Decision date: 2024-03-14. Results received: No. Last updated: 2026-07-23.
Decision dates by country: IT: 2024-03-21, DE: 2024-03-15, ES: 2024-03-14, BE: 2024-03-19

Condition(s): Duchenne Muscular Dystrophy
Product: Delandistrogene moxeparvovec-rokl

Primary endpoint: Number of Participants with a Treatment-emergent Adverse Event (TEAE), Serious Adverse Event (SAE), and Adverse Event of Special Interest (AESI)
Endpoint(s): Change in the North Star Ambulatory Assessment (NSAA) Total Score From Pre-infusion Baseline of Delandistrogene Moxeparvovec to the end of study participation, Change in Time to Rise From Floor From Pre-infusion Baseline of Delandistrogene Moxeparvovec to the end of study participation, Change in Time of 10-meter Walk/Run (10MWR) from Pre-infusion Baseline of Delandistrogene Moxeparvovec to the end of study participation., Change in Performance of Upper Limb (PUL) (Version 2.0) Total Scores from Pre-infusion Baseline of Delandistrogene Moxeparvovec to the end of study participation, Change in PUL (Version 2.0) Domain Specific Scores from Pre-infusion Baseline of Delandistrogene Moxeparvovec to the end of study participation, Change in Forced Vital Capacity Percent (FVC%) Predicted from Pre-infusion Baseline of Delandistrogene Moxeparvovec to the end of study participation, Change in Peak Expiratory Flow Percent (PEF%) Predicted from Pre-infusion Baseline of Delandistrogene Moxeparvovec to the end of study participation, Change in Cardiac Magnetic Resonance Imaging (MRI) findings from Pre-infusion Baseline of Delandistrogene Moxeparvovec to the end of study participation, Change in Musculoskeletal MRI Findings from Pre-infusion Baseline of Delandistrogene Moxeparvovec to the end of study participation

Source: https://euclinicaltrials.eu/ctis-public/view/2023-505043-39-00